EU clinical trial 2024-511179-13-00: A Randomized, Double-Blind, Placebo-Controlled, Multi-Center Study to Investigate the Efficacy and Safety of Once Daily Mexiletine PR During 26 Weeks of Treatment in Patients with Myotonic Dystrophy Type 1 and Type 2
Protocol code: MEX-DM-302
Sponsor: Lupin Atlantis Holdings SA (Pharmaceutical company). Phase: Therapeutic confirmatory (Phase III). Countries: Germany (ongoing, recruiting), Denmark (ongoing, recruiting), Italy (ongoing, recruiting), Belgium (ongoing, recruiting), Spain (ongoing, recruiting).
Therapeutic area(s): Phenomena and Processes [G] - Musculoskeletal and Neural Physiological Phenomena [G11]
Gender: Female, Male. Age: 0-17 years, 18-64 years, 65+ years. Enrolment: 146.
Status: Ongoing, recruiting. Start date (EU): 2025-01-13. Decision date: 2024-09-04. Results received: No. Last updated: 2026-08-03.
Decision dates by country: ES: 2024-09-09, IT: 2024-09-05, BE: 2024-09-04, DK: 2024-09-05, DE: 2024-09-05

Condition(s): Myotonic Dystrophy type 1 and type 2 (DM1/DM2)
Product: Placebo to Mexiletine granules for prolonged-release oral suspension 167 mg, 333 mg, and 500 mg, Mexiletine granules for prolonged-release oral suspension 500 mg, Mexiletine granules for prolonged-release oral suspension 333 mg, Mexiletine granules for prolonged-release oral suspension 167 mg

Primary endpoint: Handgrip relaxation time in DM1 patients: Mean change from baseline in relaxation time of handgrip after maximal voluntary isometric contraction (MVIC) of the dominant hand using a handgrip dynamometer at Week 26.
Endpoint(s): Handgrip Dynamometer (Week 14), Individualized Neuromuscular Quality of Life Questionnaire (INQoL) locking domain, Myotonia Behavior Scale (MBS), Visual Analog Scale (VAS) for myotonia, 10 meter Walk Test (10mWT), DM1-Active-c

Source: https://euclinicaltrials.eu/ctis-public/view/2024-511179-13-00